EU clinical trial 2024-512013-41-00: Randomized, double-blind, placebo-controlled, parallel-group Phase 3 study to evaluate the efficacy, safety, and tolerability of SAR440340/REGN3500/itepekimab (anti-IL-33 mAb) in patients with moderate-to-severe chronic obstructive pulmonary disease (COPD) (AERIFY-1)
Protocol code: EFC16750
Sponsor: Sanofi-Aventis Recherche & Developpement (Pharmaceutical company). Phase: Therapeutic confirmatory (Phase III). Countries: Romania (ended), Slovakia (ended), Bulgaria (ended), Italy (ended), Czechia (ended), Poland (ended), Hungary (ended), Greece (ended).
Therapeutic area(s): Diseases [C] - Respiratory Tract Diseases [C08]
Gender: Female, Male. Age: 18-64 years, 65+ years. Enrolment: 686.
Status: Ended. Start date (EU): 2021-03-22. End date (EU): 2025-06-24. End date: 2025-08-27. Decision date: 2024-08-06. Results received: No. Last updated: 2025-03-25.
Decision dates by country: BG: 2024-08-06, CZ: 2024-08-07, GR: 2024-10-23, HU: 2024-08-06, IT: 2024-08-12, RO: 2024-08-23, PL: 2024-08-09, SK: 2024-08-06

Condition(s): Chronic Obstructive Pulmonary Disease
Product: Itepekimab, Matched placebo for test product

Primary endpoint: Annualized rate of moderate or severe acute exacerbation of COPD (AECOPD)
Endpoint(s): Change from baseline in pre-bronchodilator (BD) forced expiratory volume in 1 second (FEV1), Change from baseline in post-BD FEV1, Change from baseline in pre-BD FEV1, Time to first moderate or severe AECOPD, Annualized rate of severe AECOPD, Time to first severe AECOPD, Annualized rate of corticosteroid-treated AECOPD, Change from baseline in Evaluating Respiratory Symptoms in COPD (E-RS:COPD) total score, Rate of change in post-BD FEV1 (L) from baseline (post-BD FEV1 slope), Change from baseline in St. George’'s Respiratory Questionnaire (SGRQ) total score, Proportion of participants with a decrease from baseline of at least 4 points in SGRQ total score, Incidence of treatment-emergent adverse events (TEAEs), adverse event of special interests (AESIs), serious adverse events (SAEs), and adverse events (AEs) leading to permanent treatment discontinuation, Incidence of potentially clinically significant laboratory test, vital signs, and electrocardiogram (ECGs) abnormalities, Functional itepekimab concentrations in serum, Incidence of treatment-emergent anti-itepekimab antibodies responses

Source: https://euclinicaltrials.eu/ctis-public/view/2024-512013-41-00